EU clinical trial 2024-513681-19-00: A randomized, double-blind, placebo-controlled Phase II proof of concept study evaluating efficacy and safety of Upadacitinib in patients with idiopathic inflammatory myopathies after withdrawal of intravenous immunoglobulins (IVIG) (IVIG-Spare)
Protocol code: IVIG-SPARE Trial
Sponsor: Medical University Of Vienna (Educational Institution). Phase: Therapeutic exploratory (Phase II). Countries: Austria (ongoing, recruiting).
Therapeutic area(s): Diseases [C] - Immune System Diseases [C20]; Diseases [C] - Skin and Connective Tissue Diseases [C17]; Diseases [C] - Musculoskeletal Diseases [C05]
Gender: Female, Male. Age: 18-64 years. Enrolment: 10.
Status: Ongoing, recruiting. Start date (EU): 2025-01-23. Decision date: 2024-10-30. Results received: No. Last updated: 2024-10-30.

Condition(s): Polymyositis, Dermatomyositis, Antisynthetase Syndrom, overlap Myositis, Immune-mediating necrotising myopathie
Product: RINVOQ 30 mg prolonged-release tablets, Placebo consists of gelatine capsules filled with maltodextrin

Primary endpoint: To assess the proportion of patients in IVIG-free stable disease activity at week 16 after randomization across two study arms comparing Upadacitinib 30 mg vs Placebo.
Endpoint(s): • Difference in proportion of patients in IVIG-free stable disease activity at week 20 between patients with Upadacitinib versus Placebo, Different proportion of patients with IVIG-free stable disease activity at week 16 and 20 using different definitions of disease worsening: (1) worsening PhGA by ≥ 2 cm NRS and worsening MMT-8 by ≥ 20%, or (2) worsening EmGA by ≥ 2 cm NRS or (3) a worsening of 3 of the 6 core set measures (HAQ-DI, MMT-8, CK, PhGA, PtGA, EmGA) by ≥ 30%., • Difference in time to first flare between patients with Upadacitinib versus Placebo, • Difference of manual muscle test between Upadacitinib and Placebo at week 16 and week 20, • Difference of patient reported outcomes, including 0- 10 numeric rating scale (NRS) of PtGA, EmGA, muscular pain, fatigue, dyspnoe and dysphagia; Quality of life, Health Assessment Questionaire Disability (HAQ-DI) between Upadacitinib and Placebo at week 16 and week 20, • Difference cumulative dose of steroids between patients with Upadacitinib versus Placebo at week 16 and 20, • Difference in laboratory parameters of values (CK, ALT, AST, LDH and aldolase) between Upadacitinib and Placebo at week 16 and week 20, • Differences in safety profile according to number of adverse events and organ systems (haematologic, hepatic, gastrointestinal, infections)

Source: https://euclinicaltrials.eu/ctis-public/view/2024-513681-19-00